EU clinical trial 2024-518608-28-00: Effect of tirzepatide on alcohol intake and reward processing in patients diagnosed with schizophrenia and alcohol use disorder
Sponsor: Psykiatrisk Center Kobenhavn (Hospital/Clinic/Other health care facility). Phase: Therapeutic exploratory (Phase II). Countries: Denmark (ongoing, recruiting).
Therapeutic area(s): Psychiatry and Psychology [F] - Mental Disorders [F03]
Gender: Female, Male. Age: 18-64 years, 65+ years. Enrolment: 108.
Status: Ongoing, recruiting. Start date (EU): 2025-05-01. Decision date: 2025-04-13. Results received: No. Last updated: 2026-01-07.

Condition(s): Schizophrenia and Alcohol Use Disorder
Product: SODIUM CHLORIDE, Mounjaro 10 mg/dose KwikPen solution for injection in pre-filled pen, Mounjaro 15 mg/dose KwikPen solution for injection in pre-filled pen, Mounjaro 7.5 mg/dose KwikPen solution for injection in pre-filled pen, Mounjaro 2.5 mg/dose KwikPen solution for injection in pre-filled pen, Mounjaro 12.5 mg/dose KwikPen solution for injection in pre-filled pen, Mounjaro 5 mg/dose KwikPen solution for injection in pre-filled pen

Primary endpoint: The primary endpoint will be a change in alcohol consumption, measured as a per cent change in heavy drinking days (days with an excess alcohol intake of 60 grams for men and 48 grams for women) after 16 weeks of treatment with tirzepatide or placebo, adjusted for the value at baseline (percentage points). Heavy drinking days will be registered using the validated Timeline-Follow-Back (TLFB) method.
Endpoint(s): Changes from baseline to after 16 weeks and after 26 weeks of treatment in total alcohol consumption measured using the TLFB method, Changes from baseline to after 16 weeks and after 26 weeks of treatment in number of days without alcohol measured using the TLFB method., Changes from baseline to after 16 weeks and after 26 weeks of treatment in World Health Organisation (WHO) alcohol risk level measured using the TLFB method., Changes from baseline to after 16 weeks and after 26 weeks of treatment in alcohol craving score using the Penn Alcohol Craving Scale (PACS) score., Changes from baseline to after 16 weeks and after 26 weeks of treatment in Alcohol Use Disorders Identification Test (AUDIT)-score, Changes from baseline to after 16 weeks and after 26 weeks of treatment in Drug Use Disorders Identification Test (DUDIT)-score, Changes from baseline to after 26 weeks of treatment in quality of life measured using the Schizophrenia Quality of Life Scale (SQLS), Changes from baseline to after 26 weeks of treatment in Clinical Global Impression Severity Scale (CGI-S), Changes from baseline to after 26 weeks of treatment in Global Assessment of Psychosocial Disability (GAPD), Changes from baseline to after 26 weeks of treatment in symptom severity of schizophrenia measured using the six-item Positive and Negative Syndrome Scale (PANSS-6), Changes from baseline to after 16 and after 26 weeks of treatment in the Patient Health Questionnaire (PHQ-9) score, Changes from baseline to after 16 weeks and after 26 weeks of treatment in smoking habits using the Fagerströms Test for Nicotine Dependence score, Changes from baseline to after 16 weeks and after 26 weeks of treatment in blood parameters (GGT, ALAT, MCV), Changes from baseline to after 16 weeks and after 26 weeks of treatment in blood phosphatidyl ethanol (PEth) levels, Changes from baseline to after 16 weeks and after 26 weeks of treatment in body weight and waist circumference, Changes from baseline to after 16 weeks and after 26 weeks of treatment in blood pressure and pulse, Changes from baseline to after 16 weeks and after 26 weeks of treatment in glycemic parameters (HbA1c), Changes from baseline to after 16 weeks and after 26 weeks of treatment in risk of liver fibrosis measured using the FIB-4 index, Changes from baseline to after 16 weeks and after 26 weeks of treatment in proteomics, For a subgroup of participants (n=50), fMRI will be conducted at baseline and after 16 weeks of treatment to evaluate: Changes in fMRI BOLD signals in response to alcohol cues in brain regions related to reward and mood and changes in resing state fMRI, Changes from baseline to after 16 weeks and after 26 weeks of treatment in blood cotinine levels, Changes from baseline to after 16 weeks and after 26 weeks of treatment in average number of cigarettes smoked per day, Changes from baseline to after 16 weeks and after 26 weeks of treatment in preferred substance of use, For a subgroup of participants (n=10), qualitative interviews will be performed after 16 weeks of treatment to evaluate qualitative differences in trial participation experiences between the intervention and placebo groups, which will be assessed as a secondary outcome., Changes in biomarkers of recent cannabis exposure (blood 11-hydroxy-delta 9-tetrahydrocannabinol (11-OH-THC) and 11-nor-9-carboxy-delta 9-tetrahydrocannabinol (THCCOOH) levels) from baseline to after 16 and 26 weeks of treatment, Changes from baseline to after 26 weeks of treatment in per cent heavy drinking days assessed using the TLFB method, Changes from baseline to after 16 weeks and after 26 weeks of treatment in the drug use frequency section of the DUDIT-extended

Source: https://euclinicaltrials.eu/ctis-public/view/2024-518608-28-00